EU clinical trial 2022-501661-47-00: INCB 39110-801 A Phase 2, Open-Label, Multicenter, Rollover Study to Provide Continued Treatment for Participants Previously Enrolled in Studies of Itacitinib (INCB039110)
Protocol code: INCB 39110-801
Sponsor: Incyte Corp. (Pharmaceutical company). Phase: Therapeutic exploratory (Phase II). Countries: Italy (ended), Spain (ended), Austria (ended), Germany (ended), Belgium (ended), Greece (ended).
Therapeutic area(s): Diseases [C] - Neoplasms [C04]
Gender: Female, Male. Age: 18-64 years, 65+ years. Enrolment: 12.
Status: Ended. Start date (EU): 2023-08-23. End date (EU): 2026-05-04. End date: 2026-05-11. Decision date: 2023-05-11. Results received: No. Last updated: 2025-09-10.
Decision dates by country: GR: 2023-06-13, IT: 2023-05-11, DE: 2023-06-05, ES: 2023-05-23, AT: 2023-05-15, BE: 2023-07-19

Condition(s): Myelofibrosis ; postlung transplant (BOS); chronic graft-versus-host disease
Product: Itacitinib, Itacitinib

Primary endpoint: Assessment of AEs and SAEs reported in participants continuing to receive itacitinib.

Source: https://euclinicaltrials.eu/ctis-public/view/2022-501661-47-00